EU clinical trial 2023-506436-33-00: GLP-1 receptor agonists as preventive treatment of diabetes after renal transplantation: a single-arm interventional clinical trial. Study 2: Patients on the waiting list for kidney transplantation.
Sponsor: Bellvitge University Hospital, Fundacio Institut D'Investigacio Biomedica De Bellvitge IDIBELL (Hospital/Clinic/Other health care facility, Laboratory/Research/Testing facility). Phase: Therapeutic confirmatory (Phase III). Countries: Spain (ended).
Therapeutic area(s): Diseases [C] - Nutritional and Metabolic Diseases [C18]
Gender: Female, Male. Age: 18-64 years, 65+ years. Enrolment: 20.
Status: Ended. Start date (EU): 2024-03-22. End date (EU): 2026-03-31. Decision date: 2023-12-01. Results received: No. Last updated: 2025-09-08.

Condition(s): Metabolic syndrome in patients on the waiting list for kidney transplantation, Metabolic syndrome in patients on the waiting list for kidney transplantation
Product: Trulicity 0.75 mg solution for injection in pre-filled pen

Primary endpoint: Proportion of patients with reversal of metabolic syndrome after 3 and 6 months of GLP1RA initiation defined by correction of metabolic syndrome (must be reduced to 1 or less defining criteria) by: (a) correction of pre-diabetes as determined by: • fasting plasma glucose of 100-126 mg/dL (5.6-6.9 mmol/L), • and/or impaired fasting glucose of <126 mg/dL (7 mmol/L) with 2 h plasma glucose after an oral glucose of 140-200 mg/dL (7.8-11 mmol/L)
Endpoint(s): Insulin sensitivity as measured by assessment of the homeostatic model calculated for insulin resistance score (HOMA-IR) and β-cell function as measured by the HOMA index of β-cell function (HOMA-B) at study inclusion, 3 and 6 months after initiation of therapy., Adverse Reactions: Gastrointestinal (nausea or diarrhea), pancreatitis, headaches, injection site pain, weakness, and severe hypoglycemic episodes defined as an episode requiring the assistance of another person to actively administer carbohydrate, glucagon, or take other corrective measures), rate of treatment discontinuation at 3 and 6 months after initiation of therapy., Changes in abdominal obesity (waist circumference and change in waist-hip ratio since enrollment in the study, at 3 and 6 months after the start of therapy)., Rate of treatment interruptions

Source: https://euclinicaltrials.eu/ctis-public/view/2023-506436-33-00